EU clinical trial 2024-512500-19-00: A pilot study using subcutaneous injections of the anti-CD38 antibody daratumumab in patients with moderate to severe Myalgic Encephalomyelitis /Chronic Fatigue Syndrome (ME/CFS)
Protocol code: KTS-9-2022
Sponsor: Helse Bergen HF (Hospital/Clinic/Other health care facility). Phase: Therapeutic exploratory (Phase II). Countries: Norway (ongoing, recruitment ended).
Therapeutic area(s): Diseases [C] - Immune System Diseases [C20]
Gender: Female, Male. Age: 18-64 years. Enrolment: 20.
Status: Ongoing, recruitment ended. Start date (EU): 2022-04-29. Decision date: 2024-07-09. Results received: No. Last updated: 2025-11-12.

Condition(s): Myalgic Encephalomyelitis/Chronic Fatigue Syndrome
Product: DARZALEX 1800 mg solution for injection

Primary endpoint: Safety and tolerability as measured by treatment-emergent adverse events.
Endpoint(s): Changes in SF36 domain scores including Physical Function and Bodily pain, from the baseline/run-in period through 40 weeks' follow-up from start of intervention, Changes in DSQ-SF scores, from the baseline/run-in period through 40 weeks' follow-up from start of intervention, Changes in patient-reported physical function, from the baseline/run-in period through 40 weeks' follow-up from start of intervention, Changes in steps per 24 hours, from the baseline/run-in period through 40 weeks' follow-up from start of intervention

Source: https://euclinicaltrials.eu/ctis-public/view/2024-512500-19-00